EU clinical trial 2024-512100-19-00: Investigating cardiometabolic risk factors and changes in chronobiology patterns in patients with autonomous adrenal cortisol secretion
Sponsor: Medical University Of Vienna (Educational Institution). Phase: Therapeutic use (Phase IV). Countries: Austria (ended).
Therapeutic area(s): Diseases [C] - Hormonal diseases [C19]
Gender: Female, Male. Age: 18-64 years, 65+ years. Enrolment: 50.
Status: Ended. Start date (EU): 2023-05-15. End date (EU): 2025-01-15. Decision date: 2024-10-14. Results received: Yes. Last updated: 2024-10-14.

Condition(s): Mild autonomous cortisol secretion in patients with adrenal adenoma
Product: Metyrapone HRA 250mg soft capsules

Primary endpoint: Hepatic lipid content (HCL) assessed by 1H magnetic resonance spectroscopy
Endpoint(s): insulin secretion and sensitivity based on validated indices (HOMA_IR, CLIX) • subcutaneous and visceral fat mass, body composition • Systolic and diastolic heart function, epicardial and pericardial fat mass • ectopic lipid deposition in the skeletal muscle and the myocardium • standardized blood pressure measurements (blood pressure for 24h hours and Schellong tests) • parameters of systemic inflammation (CRP, Il-6, PAI-1, TNF-alpha, homocysteine, leucocytes, monocytes)

Source: https://euclinicaltrials.eu/ctis-public/view/2024-512100-19-00